EU clinical trial 2022-501346-30-00: A Randomized, Open-Label, Phase 3 Trial to Compare the Efficacy and Safety of Idecabtagene Vicleucel with Lenalidomide Maintenance Versus Lenalidomide Maintenance Therapy Alone in Adult Participants with Newly Diagnosed Multiple Myeloma Who Have Suboptimal Response After Autologous Stem Cell Transplantation
Protocol code: CA089-1043
Sponsor: Celgene Corp. (Pharmaceutical company). Phase: Therapeutic confirmatory (Phase III). Countries: Belgium (ended), Poland (ongoing, recruitment ended), Spain (ongoing, recruitment ended), Austria (ended), Denmark (ended), France (ongoing, recruitment ended), Romania (ongoing, recruitment ended), Italy (ongoing, recruitment ended), Norway (ongoing, recruitment ended), Greece (ended), Czechia (ended), Germany (ended).
Therapeutic area(s): Diseases [C] - Neoplasms [C04]
Gender: Female, Male. Age: 18-64 years, 65+ years. Enrolment: 332.
Start date (EU): 2023-09-25. Decision date: 2023-09-04. Results received: No. Last updated: 2026-04-14.
Decision dates by country: AT: 2023-09-11, DK: 2023-09-04, CZ: 2024-09-05, DE: 2024-09-09, GR: 2023-09-04, FR: 2023-09-04, PL: 2023-09-11, NO: 2023-09-04, RO: 2023-09-11, ES: 2023-09-11, BE: 2023-09-06, IT: 2023-09-06

Condition(s): Newly Diagnosed Multiple Myeloma with Suboptimal Response After Autologous Stem Cell Transplantation
Product: DIPHENHYDRAMINE HYDROCHLORIDE, Revlimid 10 mg hard capsules, Revlimid 15 mg hard capsules, RoActemra 20 mg/mL concentrate for solution for infusion, Neoflubin 25 mg/ml Konzentrat zur Herstellung einer Injektions- oder Infusionslösung, Fludarabinphosphat-GRY® 25 mg/ml Konzentrat zur Herstellung einer Injektionslösung oder Infusionslösung, Fludarabin HEXAL® 25 mg/ml Konzentrat zur Herstellung einer Injektions- oder Infusionslösung, PARACETAMOL, Fludarabine Accord, 25 mg/ml, koncentrat do sporzadzania roztworu do wstrzykiwan lub infuzji, Bendarabin 50 mg Pulver zur Herstellung einer Injektions- oder Infusionslösung, Revlimid 2.5 mg hard capsules, FLUDARABINE ACCORD 25 mg/ml, solution à diluer pour solution injectable/pour perfusion, Revlimid 5 mg hard capsules, idecabtagene vicleucel, Endoxan

Primary endpoint: Progression Free Survival (PFS)
Endpoint(s): Overal Surival (OS), Percentage of Participants with Minimal Residual Disease Negative (MRDneg) Complete Response (CR) for 12 months, Percentage of Participants with Minimal Residual Disease Negative (MRDneg) Complete Response (CR), Event-Free Survival (EFS), Duration of Response (DOR), Percentage of Participants with Complete Response (CR), Time to Progression (TTP), Progression post-next line of treatment (PFS2), Time to Next Treatment (TTNT), Number of Participants Experiencing Adverse Events (AEs)., Number of Participants Experiencing Adverse Events of Special Interest (AESI), Maximum Observed Plasma Concentration (Cmax), Time of Maximum Observed Plasma Concentration (Tmax), Area Under the Curve (AUC) from time zero to 28 days post infusion (AUC [0-28D]), Time of Last Measurable Observed Plasma Concentration (Tlast), Time-to-Definitive Deterioration, Mean Change from Baseline in EORTC QLQ-C30 Selected Subscales, Mean Change from Baseline in EORTC QLQ-MY20 Selected Subscales

Source: https://euclinicaltrials.eu/ctis-public/view/2022-501346-30-00